EU clinical trial 2022-502681-24-00: A Phase 1b Study of Bispecific T Cell Redirection Antibodies in Combination with Checkpoint Inhibition for the Treatment of Participants with Relapsed or Refractory Multiple Myeloma
Protocol code: 64407564MMY1005
Sponsor: Janssen - Cilag International (Pharmaceutical company). Phase: Human Pharmacology (Phase I)- Other. Countries: Spain (ongoing, recruitment ended), France (ongoing, recruitment ended), Germany (ongoing, recruitment ended).
Therapeutic area(s): Diseases [C] - Neoplasms [C04]
Gender: Female, Male. Age: 18-64 years, 65+ years. Enrolment: 60.
Status: Ongoing, recruitment ended. Start date (EU): 2022-06-22. Decision date: 2024-04-26. Results received: No. Last updated: 2026-04-06.
Decision dates by country: DE: 2024-05-02, FR: 2024-05-02, ES: 2024-04-26

Condition(s): Relapsed or Refractory Multiple Myeloma

Source: https://euclinicaltrials.eu/ctis-public/view/2022-502681-24-00